EU clinical trial 2024-512176-35-00: The role of sonoporation-enhanced treatment with Gemcitabine, Nab-Paclitaxel and FOLFIRINOX in patients with inoperable pancreatic cancer
Sponsor: Helse Bergen HF (Hospital/Clinic/Other health care facility). Phase: Therapeutic exploratory (Phase II). Countries: Norway (ongoing, recruitment ended).
Therapeutic area(s): Diseases [C] - Neoplasms [C04]
Gender: Female, Male. Age: 18-64 years, 65+ years. Enrolment: 60.
Status: Ongoing, recruitment ended. Start date (EU): 2024-09-27. Decision date: 2024-09-26. Results received: No. Last updated: 2024-09-26.

Condition(s): Pancreatic cancer
Product: Sonazoid 8 mikroliter per ml pulver og væske til injeksjonsvæske, dispersjon, Irinotecan Accord 20 mg/ml konsentrat til infusjonsvæske, oppløsning, Kalsiumfolinat Pfizer 10 mg/ml injeksjonsvæske, oppløsning, Gemkabi 38 mg/ml konsentrat til infusjonsvæske, oppløsning, Fluorouracil Accord 50 mg/ml injeksjons-/infusjonsvæske, oppløsning, Abraxane 5 mg/ml powder for dispersion for infusion., Oksaliplatin SUN 5 mg/ml konsentrat til infusjonsvæske, oppløsning

Primary endpoint: Progression free survival based on the RECIST-criteria
Endpoint(s): Key secondary efficacy endpoint: Overall survival., Time to treatment failure, defined as time from study day 1 to disease progression (RECIST-criteria from CT) and/or rapidly deteriorating ECOG performance status., Number of completed chemotherapy cycles before treatment failure, Changes in local disease progression using RECIST-criteria (CT), Changes in maximum tumour diameter (CT and ultrasound), Changes in disease progression using primary tumour volume (CT and ultrasound)

Source: https://euclinicaltrials.eu/ctis-public/view/2024-512176-35-00